EU clinical trial 2023-507393-40-00: A multicenter, Phase 1b, double-blind, placebo-controlled study to evaluate the safety and tolerability, and the efficacy of si-544 in adults with psoriasis vulgaris or psoriatic arthritis
Protocol code: SEL-002
Sponsor: selectION Therapeutics GmbH (Pharmaceutical company). Phase: Human Pharmacology (Phase I)- Other. Countries: Germany (ended).
Therapeutic area(s): Diseases [C] - Skin and Connective Tissue Diseases [C17]
Gender: Female, Male. Age: 18-64 years, 65+ years. Enrolment: 45.
Status: Ended. Start date (EU): 2023-12-12. End date (EU): 2025-06-23. Decision date: 2023-12-07. Results received: No. Last updated: 2025-05-13.

Condition(s): psoriasis vulgaris, psoriatic arthritis

Source: https://euclinicaltrials.eu/ctis-public/view/2023-507393-40-00